EU clinical trial 2024-520336-14-00: A multicenter randomized trial of fosfomycin versus ciprofloxacin for febrile neutropenia in hematologic patients: efficacy and microbiologic safety.
Protocol code: FOVOCIP
Sponsor: Fundacion Para La Investigacion Y La Innovacion Biosanitaria Del Principado De Asturias (Laboratory/Research/Testing facility). Phase: Therapeutic confirmatory (Phase III). Countries: Spain (authorised, recruitment pending).
Therapeutic area(s): Diseases [C] - Hemic and Lymphatic Diseases [C15]; Not possible to specify
Gender: Female, Male. Age: 18-64 years, 65+ years. Enrolment: 156.
Status: Authorised, recruitment pending. Decision date: 2025-01-21. Results received: No. Last updated: 2025-01-21.

Condition(s): Post-chemotherapy neutropenia with high risk of developing infection in patients with acute leukemia undergoing induction, autologous or allogeneic hematopoietic stem cell transplantation (HSCT).
Product: FOSFOMYCIN, CIPROFLOXACIN

Primary endpoint: febrile neutropenia requiring antibacterial treatment, Absolute Neutrophil Count (ANR) >0.5x109/L, If the subject fails to achieve more than 0.5x109/L neutrophils the study will end when more than 60 days have elapsed since the onset of neutropenia, or on the first day of the next chemotherapy cycle (whichever is earlier), death

Source: https://euclinicaltrials.eu/ctis-public/view/2024-520336-14-00